EU clinical trial 2024-515592-35-00: Study of BGB-11417 in Patients with Mature B Cell Malignancies
Protocol code: BGB-11417-101
Sponsor: BeOne Medicines AG (Pharmaceutical company). Phase: Human Pharmacology (Phase I)- First administration to humans. Countries: Italy (ongoing, recruitment ended), Spain (ongoing, recruitment ended).
Therapeutic area(s): Diseases [C] - Hemic and Lymphatic Diseases [C15]
Gender: Female, Male. Age: 18-64 years, 65+ years. Enrolment: 69.
Status: Ongoing, recruitment ended. Start date (EU): 2021-06-14. Decision date: 2024-10-10. Results received: No. Last updated: 2026-05-20.
Decision dates by country: IT: 2024-10-21, ES: 2024-10-10

Condition(s): Mature B Cell Malignancies

Source: https://euclinicaltrials.eu/ctis-public/view/2024-515592-35-00